EU clinical trial 2024-512581-34-00: A Phase II, Single Arm Study Assessing the Efficacy of Osimertinib in Combination with Savolitinib in Patients with EGFRm+ and MET+, Locally Advanced or Metastatic Non Small Cell Lung Cancer who have Progressed Following Treatment with Osimertinib 2024-512581-34-00
Protocol code: SAVANNAH
Sponsor: AstraZeneca AB (Pharmaceutical company). Phase: Therapeutic exploratory (Phase II). Countries: France (ongoing, recruitment ended).
Therapeutic area(s): Diseases [C] - Neoplasms [C04]
Gender: Female, Male. Age: 18-64 years, 65+ years. Enrolment: 76.
Status: Ongoing, recruitment ended. Start date (EU): 2019-10-23. Decision date: 2024-07-24. Results received: No. Last updated: 2026-02-20.

Condition(s): EGFRm+ and MET+, Locally Advanced or Metastatic Non Small Cell Lung Cancer.
Product: Savolitinib, TAGRISSO 40 mg film-coated tablets, TAGRISSO 80 mg film-coated tablets, Savolitinib

Primary endpoint: Overall Response Rate (ORR) by investigator assessment in accordance with RECIST 1.1.
Endpoint(s): ORR by investigator assessment in accordance with RECIST 1.1., PFS by investigator assessment in accordance with RECIST 1.1. OS DoR Percentage change in tumour size by investigator assessment in accordance with RECIST 1.1., Mean change from baseline in EORTC QLQ-C30 and QLQ-LC13., Plasma concentrations of osimertinib, savolitinib and their metabolites., Total clearance in EGFR mutations at 6-weeks after therapy initiation (percentage and absolute change from baseline in EGFR mutation allele frequencies)., AEs, SAEs and discontinuation rate due to AEs. Clinical chemistry/haematology including LFTs. ECHOs, ECGs and vital signs including blood pressure and heart rate.

Source: https://euclinicaltrials.eu/ctis-public/view/2024-512581-34-00